EU clinical trial 2024-511034-12-00: Is local injection of mesenchymal stem cells after endoscopic dilation safe and does it improve the outcome of intestinal stricture in patients with Crohn's disease?
Protocol code: TJT2301
Sponsor: Centre hospitalier universitaire de Liege (Hospital/Clinic/Other health care facility). Phase: Therapeutic exploratory (Phase II). Countries: Belgium (ongoing, recruiting).
Therapeutic area(s): Diseases [C] - Digestive System Diseases [C06]
Gender: Female, Male. Age: 18-64 years, 65+ years. Enrolment: 50.
Status: Ongoing, recruiting. Start date (EU): 2026-05-20. Decision date: 2024-09-26. Results received: No. Last updated: 2026-05-19.

Condition(s): Crohn's disease
Product: The placebo will be the administration buffer of the MSCs, composed of 75% NaCL 0.9% and 25% HSA 20% (Human serum albumin). The placebo will be administred as a sigle local injection, MSC

Primary endpoint: The occurrence of adverse events (serious or not) up to week 48 for safety evaluation, A clinical response to symptomatic stricture WITH either an endoscopic response or a radiological response AND the absence of recourse to endoscopic dilation, surgery, corticosteroid therapy or therapeutic optimization of anti-inflammatory treatment currently used for Crohn's Disease at the time of the procedure, for efficacy, for primary efficacy evaluation
Endpoint(s): Evolution of Patient Reported Outcomes (PROs) and Stenosis Patient Reported Outcomes (S-PROs) between weeks 0, 24 and 48, as well as the evolution of endoscopic and radiological parameters (measured by DCE-MRI) between weeks 0, 24 and 48, for secondary efficacy evaluation.

Source: https://euclinicaltrials.eu/ctis-public/view/2024-511034-12-00